EU clinical trial 2023-509534-18-01: HEMO trial - A randomized controlled trial of heparin bolus mobilization prior to peripheral hematopoietic cell collection from patients with lymphoma or myeloma
Sponsor: Karolinska University Hospital (Hospital/Clinic/Other health care facility). Phase: Therapeutic exploratory (Phase II). Countries: Sweden (authorised, recruitment pending).
Therapeutic area(s): Diseases [C] - Hemic and Lymphatic Diseases [C15]
Gender: Female, Male. Age: 18-64 years, 65+ years. Enrolment: 100.
Status: Authorised, recruitment pending. Decision date: 2024-04-29. Results received: No. Last updated: 2024-04-29.

Condition(s): Myelom, Lymfom
Product: Heparin LEO 5000 IE/ ml injektionsvätska, lösning, Natriumklorid Baxter 9 mg/ml infusionsvätska, lösning

Primary endpoint: Utbyte efter första skördedagen, definierat som totalt antal skördade stamceller delat på försökspersonens vikt och korrigerat för processad blodvolym samt mängd stamceller i blodet vid start.
Endpoint(s): Andel försökspersoner som uppnår skördemålet och andel som avslutar skörden efter första dagen., Upprepad blodprovstagningen på ett urval av försökspersoner under skördens gång kommer att göras för att jämföra ökningen av stamceller i blodet under skördens gång avseende linjär trend eller tidpunkt för maximal lutning., En bedömning av säkerhet relaterat till heparintillförseln kommer att göras och helt baseras på journalgranskning vid ett eller flera tillfällen efter avslutad skörd för att samla in alla misstänkta blödningskomplikationer och andra oönskade händelser., Stamcellsprodukten från ett urval försökspersoner kommer att karaktäriseras bredare med hypotesgenererande inriktning med hjälp av metoder som inte ingår i klinisk rutin såsom flödescytometri, genuttryck, bestämning av lösliga proteiner eller andra molekyler.

Source: https://euclinicaltrials.eu/ctis-public/view/2023-509534-18-01